EU clinical trial 2022-500681-98-00: A randomized first-in-human, Phase 1, single-center, observer-blind, active-controlled 3-arm study to evaluate the safety, tolerability, and immunogenicity of one single administration of TETRALITE, a novel adjuvanted influenza vaccine, in healthy participants aged 18 to 50 years
Protocol code: TETRALITE-I
Sponsor: Litevax B.V. (Pharmaceutical company). Phase: Human Pharmacology (Phase I)- First administration to humans. Countries: Belgium (ended).
Therapeutic area(s): Diseases [C] - Virus Diseases [C02]
Gender: Female, Male. Age: 18-64 years. Enrolment: 60.
Status: Ended. Start date (EU): 2022-09-14. End date (EU): 2023-05-17. Decision date: 2022-08-03. Results received: Yes. Last updated: 2022-12-05.

Condition(s): Influenza
Product: Vaxigrip Tetra, suspensie voor injectie in een voorgevulde spuit Quadrivalent griepvaccin (gesplitst virion, geïnactiveerd), TETRALITE

Primary endpoint: Occurrence of solicited local and systemic AEs for 7 days after vaccination., Occurrence of unsolicited AEs for 28 days after vaccination., Occurrence of serious adverse events (SAEs), potential immune mediated disorders (pIMDs) and adverse events of special interest (AESIs) for 180 days after vaccination., Occurrence of clinically abnormal hematology and serum biochemistry laboratory values at 7 days, 28 days and 180 days after vaccination versus baseline (Day 1, pre-vaccination).
Endpoint(s): Immunogenicity of TETRALITE with different adjuvant dose levels as determined by: The HI antibody titers in serum samples against the 4 vaccine influenza strains at 7 days, 28 days and 180 days after vaccination versus baseline (Day 1, pre-vaccination)., Immunogenicity of TETRALITE with different adjuvant dose levels as determined by: The MN antibody titers in serum samples against the 4 vaccine influenza strains at 7 days, 28 days and 180 days after vaccination versus baseline (Day 1, pre-vaccination).

Source: https://euclinicaltrials.eu/ctis-public/view/2022-500681-98-00